EU clinical trial 2024-510926-19-00: RuxoTam; A phase II study to evaluate safety and efficacy of tamoxifen in combination with Ruxolitinib in patients with myelofibrosis
Sponsor: Universitair Medisch Centrum Groningen (Hospital/Clinic/Other health care facility). Phase: Therapeutic exploratory (Phase II). Countries: Netherlands (authorised, recruitment pending).
Therapeutic area(s): Diseases [C] - Neoplasms [C04]
Gender: Female, Male. Age: 18-64 years, 65+ years. Enrolment: 14.
Status: Authorised, recruitment pending. Decision date: 2025-11-11. Results received: No. Last updated: 2025-11-11.

Condition(s): Myelofibrosis

Source: https://euclinicaltrials.eu/ctis-public/view/2024-510926-19-00